EU clinical trial 2024-514525-34-00: Prospective, multicentre, randomized, double-blind, placebo-controlled clinical trial of efficacy and safety with subcutaneous immunotherapy in patients with rhinitis/rhinoconjunctivitis with or without mild to moderate asthma sensitized to grasses and olive tree
Protocol code: DMV03-SIT-027
Sponsor: Inmunotek S.L. (Pharmaceutical company). Phase: Therapeutic confirmatory (Phase III). Countries: Spain (ongoing, recruitment ended).
Therapeutic area(s): Diseases [C] - Immune System Diseases [C20]
Gender: Female, Male. Age: 0-17 years, 18-64 years. Enrolment: 180.
Status: Ongoing, recruitment ended. Start date (EU): 2024-08-18. Decision date: 2024-08-14. Results received: No. Last updated: 2025-12-02.

Condition(s): Aetiological treatment of moderate-severe intermitent or persistent allergic rhinitis/rhinoconjunctivitis with or without controlled mild-moderate intermittent or persistent allergic asthma
Product: Mixture of modified allergen extracts of 6 grasses (MG01) and modified allergen extract of olive pollen (T517), Mixture of modified allergen extracts of 6 grasses (MG01) and modified allergen extract of olive pollen (T517), Identical solution and presentation as the active treatment, but without active ingredients.

Primary endpoint: Overall symptom and medication score during the grass and olive tree pollen season (April, May, and June)
Endpoint(s): Symptom-free days, Medication-free days, Asthma exacerbations, Visual Analogue Scale (VAS), Immunological parameters: total IgE, specific IgE, specific IgG4, Asthma Control Questionnaire (ACQ-6), Rhinitis quality of life questionnaire (ESPRINT-15), Consumption of health resources, Safety of specific immunotherapy (Overall rate, severity, and ratio of any adverse event (AE) by administration and by subject; Assessment of administration site reactions, systemic reactions and any medication administered for the treatment of AE)

Source: https://euclinicaltrials.eu/ctis-public/view/2024-514525-34-00